EU clinical trial 2025-521086-28-00: Randomized clinical trial to assess the efficacy and safety of a strategy for primary prevention of cardiovascular disease in patients with inflammatory rheumatic diseases based on the use of carotid ultrasound.
Sponsor: Instituto De Investigacion Marques De Valdecilla (Laboratory/Research/Testing facility). Phase: Therapeutic use (Phase IV). Countries: Spain (authorised, recruitment pending).
Therapeutic area(s): Diseases [C] - Cardiovascular Diseases [C14]
Gender: Female, Male. Age: 18-64 years, 65+ years. Enrolment: 1250.
Status: Authorised, recruitment pending. Decision date: 2025-10-03. Results received: No. Last updated: 2026-07-14.

Condition(s): CHRONIC INFLAMMATORY RHEUMATIC DISEASE: rheumatoid arthritis or psoriatic arthritis or axial spondyloarthritis or systemic lupus erythematosus
Product: ATORVASTATIN AND AMLODIPINE, ROSUVASTATIN AND EZETIMIBE, ROSUVASTATIN AND EZETIMIBE, BEMPEDOIC ACID

Primary endpoint: occurrence of a major cardiovascular event: acute myocardial infarction or stroke, hospital admission for unstable angina, arterial revascularization for peripheral artery disease, death due to CV disease
Endpoint(s): individualized appearance of each of the cardiovascular events that make up the primary endpoint

Source: https://euclinicaltrials.eu/ctis-public/view/2025-521086-28-00